EU clinical trial 2024-518470-13-00: A Study to Evaluate the Effect of Retatrutide on Insulin Secretion and Insulin Sensitivity in Adult Participants With Type 2 Diabetes Mellitus
Protocol code: J1I-MC-GZQG
Sponsor: Eli Lilly & Co. (Pharmaceutical company). Phase: Human Pharmacology (Phase I)- Other. Countries: Germany (ongoing, recruiting).
Therapeutic area(s): Phenomena and Processes [G] - Metabolism [G03]
Gender: Female, Male. Age: 18-64 years. Enrolment: 95.
Status: Ongoing, recruiting. Start date (EU): 2025-05-30. Decision date: 2025-04-11. Results received: No. Last updated: 2026-06-08.

Condition(s): Diabetes Mellitus

Source: https://euclinicaltrials.eu/ctis-public/view/2024-518470-13-00